EU clinical trial 2024-513294-41-00: Pivmecillinam with Amoxicillin/Clavulanic acid for Step Down Oral Therapy in Febrile UTIs Caused by ESBL-producing Enterobacterales
Protocol code: TPLBIS20
Sponsor: Region Skane (Hospital/Clinic/Other health care facility). Phase: Therapeutic use (Phase IV). Countries: Sweden (ongoing, recruiting).
Therapeutic area(s): Diseases [C] - Bacterial Infections and Mycoses [C01]
Gender: Female, Male. Age: 18-64 years, 65+ years. Enrolment: 330.
Status: Ongoing, recruiting. Start date (EU): 2023-04-17. Decision date: 2024-10-28. Results received: No. Last updated: 2024-10-28.

Condition(s): Urinary tract infection and/or bacteremia caused by extended spectrum beta-lactamases-producing Enterobacterales
Product: Amoxicillin/Clavulanic acid Aurobindo 500 mg/125 mg filmdragerade tabletter, Ciprofloxacin Orion 500 mg filmdragerade tabletter, Eusaprim forte 160 mg/800 mg tabletter, Ertapenem Fresenius Kabi 1 g pulver till koncentrat till infusionsvätska, lösning, Selexid 400 mg filmdragerade tabletter

Primary endpoint: Clinical response 7 to 10 days (test of cure, TOC) after antibiotic treatment has been discontinued. The primary endpoint is met if the patient has no symptoms (i.e. resolution of fever and dysuria > 24 h) and no further antibiotic treatment is necessary, as determined by treating physician.
Endpoint(s): Growth of EPE in follow up urine culture (microbiological endpoint) at TOC., Faecal culture positive for EPE at follow up at TOC., Death from all causes within 28 days.

Source: https://euclinicaltrials.eu/ctis-public/view/2024-513294-41-00